EU clinical trial 2023-506734-73-00: Pharmacokinetics study of Cefazolin in haemodialysis (CEFAZODIAL)
Protocol code: DR220268
Sponsor: Centre Hospitalier Regional Universitaire De Tours (Hospital/Clinic/Other health care facility). Phase: Therapeutic use (Phase IV). Countries: France (ended).
Therapeutic area(s): Diseases [C] - Male Urogenital Diseases [C12]; Diseases [C] - Bacterial Infections and Mycoses [C01]
Gender: Female, Male. Age: 18-64 years, 65+ years. Enrolment: 50.
Status: Ended. Start date (EU): 2023-11-20. End date (EU): 2025-12-24. Decision date: 2023-10-05. Results received: No. Last updated: 2025-04-10.

Condition(s): Chronic haemodialysis patients suffering from infection.
Product: CEFAZOLIN

Primary endpoint: Time during which the plasma concentration of cefazolin is greater than the target concentration of 40 mg/L.
Endpoint(s): Occurrence of adverse events (within 6 weeks of last dose), Early clinical efficacy (at 1 week from start of treatment) in cefazolin-susceptible patients, defined as freedom from failure, composite endpoint including: 1/ Persistence of fever >38°C 2/ Persistence of positive blood cultures for the same germ(s) 3/ Death for infectious reasons 4/ Change of antibiotic therapy due to ineffectiveness, Late clinical efficacy (at 6 weeks from the start of treatment) in patients with cefazolin-susceptible organisms, defined as absence of failure, composite criterion including : 1/ Persistence of positive blood cultures 2/ Recurrence of initial infection 3/ Death due to infection 4/ Change of antibiotic therapy due to ineffectiveness, Each of the criteria of the 2 composite scores taken in isolation, Association of pharmacokinetic variability factors (covariates) with the occurrence of under- or over-exposure (concentration below 40mg/L or above 80mg/L)

Source: https://euclinicaltrials.eu/ctis-public/view/2023-506734-73-00